EU clinical trial 2023-508690-92-00: A multicenter rollover extension program (REP) to evaluate the long-term safety and tolerability of open label iptacopan in adult participants with primary IgA nephropathy who have completed a Novartis-sponsored iptacopan parent study in IgAN
Protocol code: CLNP023A2002B
Sponsor: Novartis Pharma AG (Pharmaceutical company). Phase: Phase III and phase IV (Integrated). Countries: Hungary (ongoing, recruitment ended), Sweden (ongoing, recruitment ended), Netherlands (ongoing, recruitment ended), Germany (ongoing, recruitment ended), Denmark (ongoing, recruitment ended), Belgium (ongoing, recruitment ended), Italy (ongoing, recruitment ended), Norway (ongoing, recruitment ended), France (ongoing, recruiting), Czechia (ongoing, recruitment ended), Slovenia (ongoing, recruitment ended), Spain (ongoing, recruiting), Slovakia (ongoing, recruitment ended).
Therapeutic area(s): Diseases [C] - Immune System Diseases [C20]
Gender: Female, Male. Age: 18-64 years, 65+ years. Enrolment: 95.
Start date (EU): 2021-09-20. Decision date: 2024-05-02. Results received: No. Last updated: 2026-07-16.
Decision dates by country: IT: 2024-05-29, SI: 2024-08-13, SE: 2024-05-02, DE: 2024-05-06, NL: 2024-05-02, HU: 2024-05-03, DK: 2024-05-02, FR: 2024-05-06, CZ: 2024-05-06, SK: 2024-08-16, BE: 2024-05-15, NO: 2024-05-03, ES: 2024-07-31

Condition(s): IgA Nephropathy
Product: IPTACOPAN

Primary endpoint: Safety and tolerability endpoints (including but not limited to AEs/SAEs, safety laboratory parameters, vital signs).
Endpoint(s): Annualized total eGFR slope., Change from baseline in eGFR., Log transformed ratio to baseline in UPCR, UACR.

Source: https://euclinicaltrials.eu/ctis-public/view/2023-508690-92-00